EU clinical trial 2024-517043-32-00: (IPCOM) Influence of Proton pump inhibitor CO-medication on the absorption of innovator and generic formulations of Mycophenolate mofetil
Protocol code: 2024-517043-32-00
Sponsor: Leids Universitair Medisch Centrum (LUMC) (Hospital/Clinic/Other health care facility). Phase: Therapeutic use (Phase IV). Countries: Netherlands (ended).
Therapeutic area(s): Diseases [C] - Immune System Diseases [C20]; Diseases [C] - Digestive System Diseases [C06]
Gender: Male. Age: 18-64 years. Enrolment: 12.
Status: Ended. Start date (EU): 2025-07-08. End date (EU): 2025-11-18. Decision date: 2025-02-28. Results received: No. Last updated: 2025-02-28.

Condition(s): Post Transplantation Patients
Product: Pantoprazole Teva 40 mg maagsapresistente tabletten, Mycophenolate mofetil Sandoz 500 mg Film-coated Tablets, Mycophenolate Mofetil Accord 500 mg plėvele dengtos tabletės, CellCept 500 mg film-coated tablets

Primary endpoint: As primary endpoint the C-max and the area under the concentration-time curve (AUC)(0-12) of MPA will be calculated. Comparisons will be made between the three formulations in AUC according to the criteria for demonstrating bio-equivalence.

Source: https://euclinicaltrials.eu/ctis-public/view/2024-517043-32-00